EU clinical trial 2024-513303-14-00: Single microdose trial - CXCR4 PET tracer - Pharmacokinetics and pharmacodynamics of [68Ga]Ga-R54, a CXCR4-targeted radiopharmaceutical in patients with advanced solid tumors.
Protocol code: R4-FOUR-PET
Sponsor: IRCCS Istituto Nazionale Tumori Fondazione Pascale (Hospital/Clinic/Other health care facility). Phase: Human Pharmacology (Phase I)- First administration to humans. Countries: Italy (ongoing, recruiting).
Therapeutic area(s): Diseases [C] - Neoplasms [C04]
Gender: Female, Male. Age: 18-64 years, 65+ years. Enrolment: 10.
Status: Ongoing, recruiting. Start date (EU): 2025-01-08. Decision date: 2024-10-15. Results received: No. Last updated: 2026-04-20.

Condition(s): Advanced solid neoplasm (breast, lung, colon, ovary, pancreas) characterized by positive CXCR4 expression by immunohistochemistry

Source: https://euclinicaltrials.eu/ctis-public/view/2024-513303-14-00